EU clinical trial 2022-500477-14-00: Digoxin for the Reinduction or Radioiodine Uptake in Metastatic or Locally Advanced Non-medullary Thyroid Carcinoma.
Protocol code: 113327
Sponsor: Stichting Radboud University Medical Center (Hospital/Clinic/Other health care facility). Phase: Therapeutic exploratory (Phase II). Countries: Netherlands (ended).
Therapeutic area(s): Diseases [C] - Neoplasms [C04]
Gender: Female, Male. Age: 18-64 years, 65+ years. Enrolment: 10.
Status: Ended. Start date (EU): 2022-11-09. End date (EU): 2023-06-21. Decision date: 2022-08-23. Results received: Yes. Last updated: 2023-02-09.

Condition(s): Non-medullary thyroid Carconoma (NMTC)
Product: Lanoxin 125, tabletten 0,125 mg, Sodium Iodide (I123) Injection, oplossing voor injectie 37 MBq/ml

Primary endpoint: The number and percentage of subjects in whom there is reinduction of RaI uptake in RaI refractory target lesions. This will be assessed using RaI scintigraphy.
Endpoint(s): The proportion of subjects with a favorable response to RaI treatment after 6 months, according to RECIST criteria., Biochemical response to RaI treatment after 6 months, measured by thyroglobulin (TG)., Toxicity assessment using CTAE criteria v4.0., Quality of life using EORTC QLQ-C30., o Correlations between molecular pattern in pre-treatment biopsies (if available) and other study endpoints.

Source: https://euclinicaltrials.eu/ctis-public/view/2022-500477-14-00